EU clinical trial 2023-508183-29-00: Effect of Roxadustat on Cardiometabolism
Sponsor: Pohjois-Pohjanmaan hyvinvointialue (Hospital/Clinic/Other health care facility). Phase: Therapeutic use (Phase IV). Countries: Finland (ongoing, recruitment ended).
Therapeutic area(s): Diseases [C] - Cardiovascular Diseases [C14]; Diseases [C] - Nutritional and Metabolic Diseases [C18]
Gender: Female, Male. Age: 18-64 years. Enrolment: 24.
Status: Ongoing, recruitment ended. Start date (EU): 2024-08-07. Decision date: 2024-04-12. Results received: No. Last updated: 2024-04-14.

Condition(s): Risk factors of cardiovascular disease, metabolic syndrome
Product: PLACEBO, Evrenzo 70 mg film-coated tablets

Primary endpoint: Plasma total cholesterol levels
Endpoint(s): Plasma LDL cholesterol and triglyceride levels, Insulin resistance and glucose tolerance, Body composition, Blood pressure, Skeletal muscle microcirculation

Source: https://euclinicaltrials.eu/ctis-public/view/2023-508183-29-00